EU clinical trial 2024-512028-12-00: IFCT-2003 ALBATROS A phase II single-group assignment, multicenter study of efficacy and safety of lorlatinib monotherapy after failure of first-line tyrosine kinase inhibitor in patients with advanced ROS1-positive non-small cell lung cancer
Protocol code: IFCT-2003
Sponsor: Intergroupe Francophone De Cancerologie Thoracique (Patient organisation/association). Phase: Therapeutic exploratory (Phase II). Countries: France (ongoing, recruitment ended).
Therapeutic area(s): Diseases [C] - Neoplasms [C04]
Gender: Female, Male. Age: 18-64 years, 65+ years. Enrolment: 84.
Status: Ongoing, recruitment ended. Start date (EU): 2021-03-19. Decision date: 2024-06-11. Results received: No. Last updated: 2025-09-17.

Condition(s): Advanced ROS1-positive non-small cell lung cancer
Product: Lorviqua 100 mg film-coated tablets, Lorviqua 25 mg film-coated tablets

Primary endpoint: The primary endpoint is the objective response rate (ORR) at 8 weeks (confirmation needed at 16 weeks) Objective response rate will be assessed by the investigators. ORR is defined as the percentage of subjects with a confirmed complete response (CR) or partial response (PR) as per RECIST v1.1 criteria.
Endpoint(s): ORR at 8 weeks, which is defined as the percentage of subjects with a confirmed at 16 weeks complete response (CR) or partial response (PR) by independent reviewer committee (IRC) as per RECIST v1.1 criteria., Progression Free Survival (PFS) defined as the time between the date of first dose of study drug and the first date of documented disease progression, as determined by Investigator review or by IRC of radiographic disease assessments per RECIST v1.1, or death due to any cause, whichever occurs first., Time to progression (TTP) defined as the time from the date of first dose of study drug to the earliest date of disease progression, as determined by Investigator review or by independent reviewer of radiographic disease assessments per RECIST v1.1., Disease control rate (DCR) at 8 weeks (confirmation needed at 16 weeks) defined as the proportion of patients have achieved a confirmed overall response of CR, PR or SD, as determined by Investigator review or by independent reviewer of radiographic disease assessments per RECIST v1.1., Duration of response (DOR) defined as the time from the date of the first documented response (CR or PR) to the earliest date of disease progression, as determined by Investigator review or by independent reviewer of radiographic disease assessments per RECIST v1.1, or death due to any cause., Overall survival (OS) defined as the time from the date of first dose of study drug to the date of death due to any cause. OS will be assessed at 12 months and at 24 months., CNS Objective response rate (C-ORR) estimated in patients with measurable CNS metastases at baseline., CNS duration of response (C-DOR) estimated in patients with measurable CNS metastases at baseline., Time to CNS progression in patients without brain metastases at baseline., Change from baseline of EuroQol Quality of Life 5-Dimension 5-Level Scale (EQ-5D-5L) at all scheduled time points.

Source: https://euclinicaltrials.eu/ctis-public/view/2024-512028-12-00